EU clinical trial 2024-518308-37-00: Affective effects of pre-surgery opioids (AFFECT2): a randomized, doubleblind placebo-controlled trial
Sponsor: Vestre Viken HF (Hospital/Clinic/Other health care facility). Phase: Therapeutic use (Phase IV). Countries: Norway (ongoing, recruitment ended).
Therapeutic area(s): Phenomena and Processes [G] - Physiological processes [G07]
Gender: Female, Male. Age: 18-64 years, 65+ years. Enrolment: 1000.
Status: Ongoing, recruitment ended. Start date (EU): 2022-12-13. Decision date: 2024-11-14. Results received: No. Last updated: 2024-11-14.

Condition(s): Health status ASA1 or ASA2 as categorised by a medical doctor at the hospital based on medical history and physical examination. The American Society of Anesthesiologists physical status (ASA1: "Healthy, non-smoking, no or minimal alcohol use" and ASA 2: "Mild diseases only without substantive functional limitations). Being eligible for day surgery means participants are overtly healthy as determined by clinical staff, but also inpatients undergoing surgery who are ASA 1 and 2.
Product: OXYCODONE, MORPHINE, FENTANYL, NaCl, ELECTROLYTES

Primary endpoint: The primary endpoints will be the mean ratings for each drug as follows (rated by the participants on the operating table using a verbal numeric rating scale (NRS 0-10))., Self-report items: - Numeric rating scales (0-10) on affective states ( pre-drug rating): Good, pain,relaxed,anxious, After IV drug administration, the patients is asked to indicate when they first feel a drug effect, and the time (seconds post-administration) is recorded along with the patient's description of this effect, after a standardized waiting time (2 min)the study personnel ask further questions about the patients' affective state. In the case that no effect has been indicated within the first two minutes, patients are asked if they feel an effect and if so, to describe it. The patient is then asked to report on an NRS 0-10, again how "good", "anxious", "pain", and "relaxed" they feel on a numerical rating scale NRS 0-10. We also measure acute drug effects such as "high", "liking the effect", "disli
Endpoint(s): Mean differences on the objective measures pre- and post opioid administration between the different drug groups: -HRV (heartrate variability), Multiple regressions will be fit to the subjective outcome measures (post-opioid) to investigate variability explained by measures at preopioid. Specifically, the predictor value of measures identified as risk factors for problematic opioid use in previous studies (e.g. prior opioid use, SUD and depression) will be assessed on the subjective items below: • Good • Pain • anxious • Relaxed • Drug high • Euphoric • Drug liking

Source: https://euclinicaltrials.eu/ctis-public/view/2024-518308-37-00